EU clinical trial 2024-514231-26-00: TherVacB_Phase1a: Open phase 1a trial to assess the safety and immunogenicity of a heterologous protein prime/MVA boost therapeutic hepatitis B vaccine candidate in healthy volunteers
Protocol code: TherVacB_Phase1a
Sponsor: University Medical Center Hamburg-Eppendorf (Hospital/Clinic/Other health care facility). Phase: Human Pharmacology (Phase I)- First administration to humans. Countries: Germany (ended).
Therapeutic area(s): Diseases [C] - Virus Diseases [C02]
Gender: Female, Male. Age: 18-64 years. Enrolment: 30.
Status: Ended. Start date (EU): 2025-07-08. End date (EU): 2026-05-21. Decision date: 2024-10-28. Results received: No. Last updated: 2025-07-04.

Condition(s): Chronic Hepatitis B

Source: https://euclinicaltrials.eu/ctis-public/view/2024-514231-26-00